EU clinical trial 2024-520052-19-04: Research on two creams (Monobenzon / Imiquimod) together with the standard treatment for advanced or metastatic melanoma (ImMI).
Protocol code: ImmunizeMI
Sponsor: Amsterdam UMC Stichting (Patient organisation/association). Phase: Phase I and Phase II (Integrated)- Other. Countries: Netherlands (authorised, recruitment pending).
Therapeutic area(s): Analytical, Diagnostic and Therapeutic Techniques and Equipment [E] - Therapeutics [E02]; Diseases [C] - Neoplasms [C04]
Gender: Female, Male. Age: 18-64 years, 65+ years. Enrolment: 18.
Status: Authorised, recruitment pending. Decision date: 2026-04-13. Results received: No. Last updated: 2026-04-13.

Condition(s): Malignant Melanoma

Source: https://euclinicaltrials.eu/ctis-public/view/2024-520052-19-04